EU clinical trial 2025-524310-28-00: A Study Evaluating the Safety and Tolerability of a Novel Formulation of QRL-101 in Healthy Participants
Protocol code: QRL-101-08
Sponsor: Quralis Corp. (Pharmaceutical company). Phase: Human Pharmacology (Phase I)- Other. Countries: Netherlands (ongoing, recruiting).
Therapeutic area(s): Diseases [C] - Nervous System Diseases [C10]
Gender: Female, Male. Age: 18-64 years, 65+ years. Enrolment: 48.
Status: Ongoing, recruiting. Start date (EU): 2026-02-02. Decision date: 2026-01-23. Results received: No. Last updated: 2026-01-23.

Condition(s): Epilepsy, amotrophic lateral sclerosis, neuropathy

Source: https://euclinicaltrials.eu/ctis-public/view/2025-524310-28-00